EU clinical trial 2023-509866-39-00: Trastuzumab Deruxtecan, and pembrolizumab in participants with Locally Advanced/Metastatic Breast or Non-Small Cell Lung Cancer
Protocol code: DS8201-A-U106
Sponsor: Daiichi Sankyo Inc. (Pharmaceutical company). Phase: Human Pharmacology (Phase I)- Other. Countries: France (ended), Spain (ended).
Therapeutic area(s): Diseases [C] - Neoplasms [C04]
Gender: Female, Male. Age: 18-64 years, 65+ years. Enrolment: 76.
Status: Ended. Start date (EU): 2020-02-14. End date (EU): 2026-06-10. Decision date: 2024-10-24. Results received: No. Last updated: 2026-05-11.
Decision dates by country: FR: 2024-11-07, ES: 2024-10-24

Condition(s): Locally advanced/metastatic breast or non-small cell lung cancer

Source: https://euclinicaltrials.eu/ctis-public/view/2023-509866-39-00